EU clinical trial 2023-504964-41-00: A Phase 1/2a Study Evaluating the Effects of ARO-MMP7 Inhalation Solution in Healthy Subjects and Patients with Idiopathic Pulmonary Fibrosis
Protocol code: AROMMP7-1001
Sponsor: Arrowhead Pharmaceuticals Inc. (Pharmaceutical company). Phase: Phase I and Phase II (Integrated)- First administration to humans. Countries: Spain (ended), Denmark (ended), Italy (ended).
Therapeutic area(s): Diseases [C] - Respiratory Tract Diseases [C08]
Gender: Female, Male. Age: 18-64 years, 65+ years. Enrolment: 15.
Status: Ended. Start date (EU): 2024-11-06. End date (EU): 2025-07-30. End date: 2025-10-06. Decision date: 2023-10-06. Results received: No. Last updated: 2025-04-15.
Decision dates by country: DK: 2023-10-09, ES: 2023-10-06, IT: 2023-10-09

Condition(s): Idiopathic pulmonary fibrosis

Source: https://euclinicaltrials.eu/ctis-public/view/2023-504964-41-00